EU clinical trial 2023-506842-22-00: A Phase 1, First-in-Human, Open-Label, Dose-Escalation and Expansion Study of IMGN151 (anti-FRα antibody-drug conjugate) in Adult Patients with Recurrent Gynaecological Cancers
Protocol code: IMGN151-1001
Sponsor: AbbVie Deutschland GmbH & Co. KG (Pharmaceutical company). Phase: Phase I and Phase II (Integrated)- First administration to humans. Countries: Germany (ended), Ireland (ongoing, recruitment ended), Belgium (ongoing, recruitment ended), Spain (ongoing, recruitment ended), Italy (ongoing, recruitment ended), France (ongoing, recruitment ended), Netherlands (ongoing, recruitment ended).
Therapeutic area(s): Diseases [C] - Neoplasms [C04]
Gender: Female. Age: 18-64 years, 65+ years. Enrolment: 142.
Start date (EU): 2025-05-19. Decision date: 2024-08-12. Results received: No. Last updated: 2026-06-04.
Decision dates by country: DE: 2024-08-16, ES: 2024-08-12, FR: 2024-08-19, NL: 2024-08-15, IT: 2024-08-13, IE: 2024-08-16, BE: 2024-08-13

Condition(s): Recurrent endometrial cancer, recurrent epithelial ovarian, fallopian tube, and primary peritoneal cancer (EOC), recurrent cervical cancer
Product: Pred Forte 1% w/v, Eye Drops Suspension, Pred Forte 10 mg/ml colirio en suspensión, Brimonidine Tartrate 0.2% w/v Eye Drops., Alphagan 2 mg/ml colirio en solución, IMGN151

Primary endpoint: Co-Primary Endpoints: Incidence of adverse events (AEs), serious adverse events (SAEs), and DLTs; Determine the recommended dose of IMGN151 monotherapy
Endpoint(s): PK parameters of IMGN151 conjugate, total antibody, DM51 and S-methyl DM51 and incidence of treatment-emergent anti-drug antibodies (ADAs), ORR (which includes best response of complete response [CR] or partial response [PR] as assessed by the investigator) per Response Evaluation Criteria in Solid Tumors (RECIST) v1.1 criteria, DOR (defined as the time from initial response [CR or PR] until radiological progressive disease [PD] per RECIST v1.1, as assessed by the investigator, or death, whichever occurs first)

Source: https://euclinicaltrials.eu/ctis-public/view/2023-506842-22-00